EU clinical trial 2024-518733-29-00: Randomized controlled double-blind study ESKAPE : ESKetamine low-dose versus ketamine low-dose for Severe Acute Pain in Emergency Departments, comparison of PsychodyslEptic effects
Protocol code: 24-PP-09
Sponsor: Centre Hospitalier Universitaire De Nice (Hospital/Clinic/Other health care facility). Phase: Therapeutic use (Phase IV). Countries: France (ended).
Therapeutic area(s): Analytical, Diagnostic and Therapeutic Techniques and Equipment [E] - Anesthesia and Analgesia [E03]
Gender: Female, Male. Age: 18-64 years, 65+ years. Enrolment: 74.
Status: Ended. Start date (EU): 2025-04-29. End date (EU): 2026-05-05. Decision date: 2025-03-06. Results received: No. Last updated: 2025-05-27.

Condition(s): Severe acute pain
Product: ESKETAMINE IDD 25 mg/mL, solution injectable/pour perfusion, KETAMINE RENAUDIN 50 mg/ml, solution injectable

Primary endpoint: Proportion of patients experiencing at least one psychodysleptic effect, in the control group (ketamine IV 0.3 mg/kg) and in the active group (esketamine IV 0.15 mg/kg). We used the SERSDA (Side Effects Rating Scale for Dissociate Anesthetics) scale, the most widely used in studies, with 9 items. The presence of one of these 9 items will be assessed by patients every 5 minutes from t0 (start of infusion) to t0 + 60 minutes.
Endpoint(s): Assess the intensity of psychodysleptic effects described by patients, Compare the analgesic efficacy of the 2 molecules during the first hour of treatment: evolution of EN pain scores over time ; proportion of patients reporting relief (EN≤3/10); rate of recourse to additional analgesia (“rescue analgesia”)., Define the proportion of other possible adverse effects or abnormal vital constants measured every 15 minutes from t0 to t0 + 60 minutes.

Source: https://euclinicaltrials.eu/ctis-public/view/2024-518733-29-00